EU clinical trial 2026-525944-14-00: Bioequivalence clinical trial of two formulations of canagliflozin
Protocol code: N-CAN-25-302
Sponsor: Laboratorios Normon S.A. (Pharmaceutical company). Phase: Human Pharmacology (Phase I)- Bioequivalence Study. Countries: Spain (ended).
Therapeutic area(s): Not possible to specify
Gender: Female, Male. Age: 18-64 years. Enrolment: 36.
Status: Ended. Start date (EU): 2026-05-14. End date (EU): 2026-06-23. Decision date: 2026-04-29. Results received: No. Last updated: 2026-04-29.

Condition(s): Healthy volunteers

Source: https://euclinicaltrials.eu/ctis-public/view/2026-525944-14-00